EU clinical trial 2025-521273-14-00: Monocentric, open-label, single-arm, phase I/II clinical trial to evaluate the use of the ONCOGREEN galenic formulation consisting of indocyanine green (ICG) with autologous extracellular vesicles (EVs) for in vivo diagnostics of solid neoplasms undergoing surgical removal - ONCOGREEN study
Protocol code: ONCOGREEN
Sponsor: Universita Degli Studi Di Milano (Educational Institution). Phase: Phase I and Phase II (Integrated)- First administration to humans. Countries: Italy (ongoing, recruiting).
Therapeutic area(s): Diseases [C] - Neoplasms [C04]; Diseases [C] - Digestive System Diseases [C06]
Gender: Female, Male. Age: 18-64 years, 65+ years. Enrolment: 44.
Status: Ongoing, recruiting. Start date (EU): 2025-11-10. Decision date: 2025-06-20. Results received: No. Last updated: 2025-10-08.

Condition(s): Solid neoplasms of the digestive system (primary and/or metastatic colon-rectal tumors, gastric tumors, tumors of the hepato-bilio-pancreatic and neuroendocrine districts) treatable with surgical resection for curative purposes
Product: VERDYE 5 mg/ml polvere per soluzione iniettabile, VERDYE 5 mg/ml polvere per soluzione iniettabile

Primary endpoint: Phase I: Evaluation of overall safety profile characterized by occurrence of DLTs, type, severity and duration of the adverse events. Phase II: Presence of tumor at histological examination in all surgical specimens that are visualized with OncoGreen in vivo and absence in non-visualized lesions: the procedure will be deemed effective if the tumor tissue is present in at least 75% of visualized lesions and absent in 75% of non-visualized lesions; otherwise, it will be considered ineffective.
Endpoint(s): Phase I - Pharmacokinetic parameters (maximum concentration [Cmax], area under the curve [AUC], and half-life [t1/2]) of ICG in the presence of EVs., Phase II - 1.Intraoperative imaging success rate (iSR): success in obtaining intraoperative visualization of the tumor tissue., Phase II - 2.Percentage of success in obtaining adequate post-operative imaging (post-operative imaging success rate, pSR)., Phase II - 3.Percentage of success in obtaining adequate microscopic imaging (microscopic imaging success rate, mSR)., Phase II - 4.In vivo and ex vivo intensity of tumor fluorescence., Phase II - 5.Imaging sensitivity., Phase II - 6.Imaging specificity., Phase II - 7.TBR: tumor-to-background ratio., Phase II - 8.ICG delivery rate to the tumor tissue., Phase II - 9.Percentage of cases where new (previously undetected) disease locations are identified., Phase II - 10.Percentage of patients with treatment emergent adverse events as defined by CTCAE v.5.0., Phase II - 11.Maximum grade of each adverse event as defined by CTCAE v.5.0., Phase II - 12.Local recurrence-free survival (LocRFS).

Source: https://euclinicaltrials.eu/ctis-public/view/2025-521273-14-00